EU clinical trial 2023-505314-20-00: A Phase 2, Multicenter, Randomized, Double-blind, Placebo-controlled, Parallel-group Study to Evaluate the Efficacy and Safety of Nipocalimab in Participants with Active Idiopathic Inflammatory Myopathies
Protocol code: 80202135IIM2001
Sponsor: Janssen - Cilag International (Pharmaceutical company). Phase: Therapeutic exploratory (Phase II). Countries: Hungary (ended), Poland (ended), Czechia (ongoing, recruitment ended), Italy (ended), Germany (ended), France (ended), Spain (ended).
Therapeutic area(s): Diseases [C] - Nervous System Diseases [C10]
Gender: Female, Male. Age: 18-64 years, 65+ years. Enrolment: 62.
Start date (EU): 2023-01-20. Decision date: 2024-02-01. Results received: No. Last updated: 2026-04-14.
Decision dates by country: DE: 2024-02-01, FR: 2024-02-16, PL: 2024-02-09, HU: 2024-02-05, ES: 2024-02-06, IT: 2024-02-05, CZ: 2024-02-06

Condition(s): Active Idiopathic Inflammatory Myopathies (IIM)
Product: JNJ-80202135, JNJ-80202135, Saline, 0.9% Sodium Chloride Solution for Injection

Primary endpoint: Proportion Percentage of participants who achieve at least minimal improvement (≥ 20-point improvement) in IMACS TIS (International myositis assessment and clinical studies total improvement score) at Week 52 and on ≤5 mg/day of oral prednisone (or equivalent) from week 44 through week 52.

Source: https://euclinicaltrials.eu/ctis-public/view/2023-505314-20-00